EU clinical trial 2023-507975-23-01: Pain Relief at Screening for Retinopathy of Prematurity - The PROPER study
Protocol code: DEX2025
Sponsor: St. Olavs Hospital HF (Hospital/Clinic/Other health care facility). Phase: Therapeutic exploratory (Phase II). Countries: Norway (authorised, recruitment pending).
Therapeutic area(s): Diseases [C] - Eye Diseases [C11]; Analytical, Diagnostic and Therapeutic Techniques and Equipment [E] - Anesthesia and Analgesia [E03]
Gender: Female, Male. Age: 0-17 years. Enrolment: 33.
Status: Authorised, recruitment pending. Decision date: 2026-06-22. Results received: No. Last updated: 2026-06-22.

Condition(s): Retinopathy of prematurity
Product: Oxibuprokain Minims 4 mg/ml øyedråper, oppløsning., Dexmedetomidine 100 micrograms/ml concentrate for solution for infusion, Metaoxedrin Minims 100 mg/ml øyedråper, oppløsning, NaCl 0,9 % B. Braun, Injektionslösung, Cyclopentolat Minims 10 mg/ml øyedråper, oppløsning

Primary endpoint: Pain score assessed with the Premature Infant Pain Profile-Revised (PIPP-R) during the 30 seconds following speculum insertion (Eye exam I and II)
Endpoint(s): 1.HR, RR, oxygen saturation, and supplemental oxygen requirement 2. Number of cardiorespiratory events. 3. PIPP-R score following speculum removal. 4. Change in respiratory support mode. 5. Duration of first cry episode. 6. Total sleep duration. 7. Number of vomiting episodes. 8. Cerebral blood flow velocities. Exploratory endp: 1.NeoDoppler blood flow patterns. 2. Cerebral Doppler velocities and pain score. 3. Ophthalmologist VAS score

Source: https://euclinicaltrials.eu/ctis-public/view/2023-507975-23-01